EU clinical trial 2026-525830-49-00: A Phase 1 Randomized, Double-Blind, placebo-controlled, clinical study to evaluate safety and Pharmacokinetics, of Single Ascending Doses and Multiple Ascending Doses of AIK3a305 in Healthy Volunteers
Protocol code: AIK3a305_P1_SADMAD
Sponsor: Allinky Biopharma S.L. (Pharmaceutical company). Phase: Human Pharmacology (Phase I)- First administration to humans. Countries: Spain (authorised, recruitment pending).
Therapeutic area(s): Not possible to specify
Gender: Female, Male. Age: 18-64 years. Enrolment: 42.
Status: Authorised, recruitment pending. Decision date: 2026-06-29. Results received: No. Last updated: 2026-06-29.

Condition(s): Treatment of several inflammatory diseases, including inflammation-related fibrosis and autoinflammatory diseases

Source: https://euclinicaltrials.eu/ctis-public/view/2026-525830-49-00